EU clinical trial 2026-525531-16-00: A Randomized Phase III Study to Investigate the Efficacy and Safety of Alpha1H as a Neoadjuvant Therapy in Participants with Low- to Intermediate-Risk/Low-Grade Papillary Non-Muscle Invasive Bladder Cancer
Protocol code: HP003-001
Sponsor: Hamlet BioPharma AB (Industry). Phase: Therapeutic confirmatory (Phase III). Countries: Czechia (authorised, recruitment pending).
Therapeutic area(s): Diseases [C] - Female Urogenital Diseases and Pregnancy Complications [C13]; Diseases [C] - Male Urogenital Diseases [C12]
Gender: Female, Male. Age: 18-64 years, 65+ years. Enrolment: 169.
Status: Authorised, recruitment pending. Decision date: 2026-06-29. Results received: No. Last updated: 2026-06-29.

Condition(s): Non-Muscle Invasive Papillary Bladder Cancer
Product: alpha 1H

Primary endpoint: Event-Free Survival is defined as the time from randomization to the earliest occurrence of: i) Recurrence of NMIBC (any grade or stage), ii) Progression to muscle-invasive bladder cancer (MIBC), iii) Development of metastatic bladder cancer, iv) Death from any cause
Endpoint(s): CR rate in the Alpha1H arm compared to SOC., Overall Survival in Alpha1H arm compared to SOC., Tumor response to Alpha1H based on change in tumor size, cell numbers in urine, properties of shed tumor cells and induction of apoptosis., Tumor response defined by cancer-related gene expression in tissue samples and urine RNA., Protein biomarkers/immune response to Alpha1H in the urine of patients pre- and post-Alpha1H treatment., Correlation between tumor cell shedding and recurrence or CR failure in study population., Tissue accumulation of Alpha1H., Safety and tolerability of Alpha1H., Incidence and severity of treatment-emergent adverse events (AEs) and complications attributable to intravesical instillation of Alpha 1H (dysuria, urinary frequency/urgency, urinary retention, hematuria)., Quality of Life (QOL) changes based on Patient-Reported-Outcomes (QLQ-NMIBC24]) from baseline to follow-up visit.

Source: https://euclinicaltrials.eu/ctis-public/view/2026-525531-16-00